EU clinical trial 2024-518399-29-00: A Randomized Phase III Study Comparing One Course of Adjuvant Bleomycin, Etoposide and Cisplatin (BEP) and One Course of Carboplatin AUC7 in Clinical Stage I Seminomatous Testicular Cancer
Protocol code: SWENOTECA
Sponsor: St. Olavs Hospital HF (Hospital/Clinic/Other health care facility). Phase: Therapeutic confirmatory (Phase III). Countries: Sweden (authorised, recruiting), Norway (authorised, recruiting).
Therapeutic area(s): Diseases [C] - Neoplasms [C04]
Gender: Male. Age: 18-64 years. Enrolment: 348.
Status: Authorised, recruiting. Start date (EU): 2024-12-27. Decision date: 2024-12-18. Results received: No. Last updated: 2025-09-10.
Decision dates by country: SE: 2024-12-18, NO: 2024-12-18

Condition(s): Testicular cancer
Product: CARBOPLATIN, BLEOMYCIN, CISPLATIN, ETOPOSIDE

Primary endpoint: Relapse rate
Endpoint(s): Short-term toxicity, Long-term toxicity, Health related quality of life, Overall survival, Health economy analysis

Source: https://euclinicaltrials.eu/ctis-public/view/2024-518399-29-00